EU clinical trial 2023-509602-29-00: A Phase III, Randomized, Double-blind, Placebo-controlled, Multi-center, International Study of Durvalumab or Durvalumab and Tremelimumab as Consolidation Treatment for Patients with Limited Stage Small-Cell Lung Cancer Who Have Not Progressed Following Concurrent Chemoradiation Therapy (ADRIATIC)
Protocol code: D933QC00001
Sponsor: AstraZeneca AB (Pharmaceutical company). Phase: Therapeutic confirmatory (Phase III). Countries: Germany (ongoing, recruitment ended), Belgium (ongoing, recruitment ended), Italy (ongoing, recruitment ended), Spain (ongoing, recruitment ended), Netherlands (ongoing, recruitment ended), Czechia (ongoing, recruitment ended), Poland (ongoing, recruitment ended).
Therapeutic area(s): Diseases [C] - Neoplasms [C04]
Gender: Female, Male. Age: 18-64 years, 65+ years. Enrolment: 168.
Status: Ongoing, recruitment ended. Start date (EU): 2019-02-11. Decision date: 2024-06-27. Results received: No. Last updated: 2025-08-21.
Decision dates by country: DE: 2024-07-03, PL: 2024-07-10, CZ: 2024-06-28, BE: 2024-06-28, ES: 2024-06-27, NL: 2024-06-27, IT: 2024-07-02

Condition(s): Patients with Limited Stage Small-Cell Lung Cancer (LS-SCLC)
Product: INFLIXIMAB, SODIUM CHLORIDE, IMFINZI 50 mg/mL concentrate for solution for infusion., MYCOPHENOLATE MOFETIL, IMJUDO 20 mg/ml concentrate for solution for infusion., DEXTROSE BP

Primary endpoint: PFS using BICR assessments according to RECIST 1.1 OS
Endpoint(s): PFS, ORR, PFS18, PFS24, and TTDM using BICR assessments according to RECIST 1.1 OS, OS24, OS36 PFS2 EORTC QLQ-C30 and QLQ-LC13: change in symptoms, functioning, and global health status/QoL Concentration of durvalumab and tremelimumab in serum (such as peak concentration and trough; sparse sampling) Presence of ADA for durvalumab and tremelimumab, PD-L1 expression in tumor and/or immune cells relative to response/efficacy outcomes (PFS, OS, and ORR). Safety assessment: AEs; laboratory findings including clinical chemistry, hematology, urinalysis; physical examinations; vital signs including blood pressure and pulse; and electrocardiograms

Source: https://euclinicaltrials.eu/ctis-public/view/2023-509602-29-00